EU clinical trial 2023-508321-27-00: A first-in-human proof-of-concept study with NVDX3, an osteogenic implant of human allogenic origin, in the treatment of distal radius fractures in adults.
Sponsor: Novadip Biosciences (Pharmaceutical company). Phase: Phase I and Phase II (Integrated)- First administration to humans. Countries: Luxembourg (ended).
Therapeutic area(s): Diseases [C] - Musculoskeletal Diseases [C05]
Gender: Female, Male. Age: 18-64 years. Enrolment: 10.
Status: Ended. Start date (EU): 2023-08-08. End date (EU): 2024-12-19. Decision date: 2024-01-18. Results received: No. Last updated: 2025-02-11.

Condition(s): Distal radius fractures

Source: https://euclinicaltrials.eu/ctis-public/view/2023-508321-27-00